EU clinical trial 2024-514983-23-01: A clinical study of sacituzumab tirumotecan (sac-TMT) in people with bladder cancer (MK-2870-027)
Protocol code: MK-2870-027
Sponsor: Merck Sharp & Dohme LLC (Pharmaceutical company). Phase: Phase I and Phase II (Integrated)- Other. Countries: Spain (ongoing, recruiting), France (ongoing, recruiting), Netherlands (ongoing, recruiting).
Therapeutic area(s): Diseases [C] - Neoplasms [C04]
Gender: Female, Male. Age: 18-64 years, 65+ years. Enrolment: 31.
Status: Ongoing, recruiting. Start date (EU): 2024-12-16. Decision date: 2024-12-13. Results received: No. Last updated: 2026-06-15.
Decision dates by country: NL: 2025-03-31, FR: 2025-03-18, ES: 2024-12-13

Condition(s): Intermediate-risk Non-muscle Invasive Bladder Cancer

Source: https://euclinicaltrials.eu/ctis-public/view/2024-514983-23-01